EU clinical trial 2025-522744-40-00: A research study to see how NNC0487-0111 affects the body’s energy use after a weight loss in adults living with obesity, compared to a low-calorie diet or placebo
Protocol code: NN9490-8152
Sponsor: Novo Nordisk A/S (Pharmaceutical company). Phase: Human Pharmacology (Phase I)- Other. Countries: Netherlands (authorised, recruiting), Denmark (authorised, recruitment pending).
Therapeutic area(s): Diseases [C] - Nutritional and Metabolic Diseases [C18]
Gender: Female, Male. Age: 18-64 years, 65+ years. Enrolment: 120.
Start date (EU): 2026-07-31. Decision date: 2026-05-11. Results received: No. Last updated: 2026-05-12.
Decision dates by country: DK: 2026-05-11, NL: 2026-05-12

Condition(s): Obesity

Source: https://euclinicaltrials.eu/ctis-public/view/2025-522744-40-00